EU clinical trial 2025-521331-36-00: MAINRITSys : Rituximab vs placebo for maintenance in systemic sclerosis – interstitial lung disease
Protocol code: APHP240909
Sponsor: Assistance Publique Hopitaux De Paris (Hospital/Clinic/Other health care facility). Phase: Phase II and Phase III (Integrated). Countries: France (authorised, recruitment pending).
Therapeutic area(s): Diseases [C] - Skin and Connective Tissue Diseases [C17]; Diseases [C] - Musculoskeletal Diseases [C05]
Gender: Female, Male. Age: 18-64 years, 65+ years. Enrolment: 120.
Status: Authorised, recruitment pending. Decision date: 2026-05-11. Results received: No. Last updated: 2026-07-09.

Condition(s): Patient with stabilized SSc-ILD (as defined by a decline of FVC ≤ 5%) following RTX induction treatment
Product: SODIUM CHLORIDE, Truxima 500 mg concentrate for solution for infusion

Primary endpoint: The absolute rate of changes in FVC from baseline to Month 18 of randomization.
Endpoint(s): Safety and tolerability profile at 6, 12, and 18 months, Disease-related mortality at 6, 12, and 18 months, Progression-free survival (composite endpoint of mortality, transplant, treatment failure or decline in FVC >10% compared to baseline) at 6, 12, and 18 months, Treatment failure (as determined by need for transplant or rescue therapy at 6, 12, and 18 months, Changes in FVC and diffusing capacity for carbon monoxide (DLCO) at 6, 12, and 18 months, Change in 6-min walk test distance over 6, 12, and 18 months, Changes from baseline to 18 months in HRCT of chest images at 6, 12, and 18 months, Scleroderma-specific endpoints (SSc disease activity revised CRISS, mRSS) at 6, 12, and 18 months, Change from baseline in health-related quality of life scores (St. George’s Respiratory Questionnaire (SGRQ), Short form (36) Health Questionnaire (SF-36), King’s Brief Interstitial Lung Disease (K-BILD), handicap questionnaires HAQ-DI, SHAQ, and patients reported outcomes questionnaires SSPRO and ScleroID) at 6, 12, and 18 months, QALYs (estimated from EQ5D5Lscores) at 6, 12, and 18 months, Hospitalisation for respiratory cause over the duration of the trial, Time to first hospitalisation for respiratory cause,, Time to first acute ILD exacerbation, Time to death

Source: https://euclinicaltrials.eu/ctis-public/view/2025-521331-36-00